EU clinical trial 2022-501694-39-01: A Prospective Study Comparing [18F]mFBG PET-CT to [123I]mIBG Scanning in Neuroblastoma
Protocol code: PS22PET
Sponsor: Princess Maxima Center For Pediatric Oncology (Hospital/Clinic/Other health care facility). Phase: Phase I and Phase II (Integrated)- Other. Countries: Netherlands (ongoing, recruiting).
Therapeutic area(s): Diseases [C] - Neoplasms [C04]; Analytical, Diagnostic and Therapeutic Techniques and Equipment [E] - Diagnosis [E01]
Gender: Female, Male. Age: 0-17 years, 18-64 years. Enrolment: 58.
Status: Ongoing, recruiting. Start date (EU): 2024-11-12. Decision date: 2024-09-23. Results received: No. Last updated: 2025-10-16.

Condition(s): (suspision on) Neuroblastoma
Product: IOBENGUANE (123I), [18F]meta-fluorobenzylguanidine

Primary endpoint: Detected skeletal lesions on [18F]mFBG PET-CT and [123I]mIBG scanning
Endpoint(s): Detected soft tissue lesions on [18F]mFBG and [123I]mIBG scanning, Radiation absorbed doses (mSv) for organs and tumour of [18F]mFBG imaging, Mean difference in number of detected lesions and limits of agreement, Cohen’s kappa, SUVmean for normal organs, SUVmax for tumour lesions

Source: https://euclinicaltrials.eu/ctis-public/view/2022-501694-39-01